EU clinical trial 2024-515102-12-00: A Modular Phase 2a Multicentre Open-Label Study to Investigate DNA-damage Response Agents (or Combinations) in Patients With Advanced Cancer Whose Tumours Contain Molecular Alterations (PLANETTE)
Protocol code: D5339C00001
Sponsor: AstraZeneca AB (Pharmaceutical company). Phase: Therapeutic exploratory (Phase II). Countries: France (ended).
Therapeutic area(s): Diseases [C] - Neoplasms [C04]
Gender: Female, Male. Age: 18-64 years, 65+ years. Enrolment: 1.
Status: Ended. Start date (EU): 2021-11-02. End date (EU): 2024-10-15. End date: 2025-02-18. Decision date: 2024-08-12. Results received: Yes. Last updated: 2024-08-12.

Condition(s): Advanced Cancer Whose Tumours Contain Molecular Alterations
Product: AZD6738, Ceralasertib

Primary endpoint: Module 1 - Cohort A: - Investigator assessed ORR, as defined by RECIST version 1.1., Module 1 - Cohort B: -Composite response rate (investigator assessed radiological response as defined by RECIST 1.1 for soft tissue and visceral lesions and by PCWG3 for bone lesions, PSA decline, and/or CTC conversion).
Endpoint(s): For Core: - AEs/SAEs - Vital signs, ECG, clinical chemistry, haematology, urinalysis and coagulation parameters., Module 1 - AEs/SAEs - Vital signs, haematology and clinical chemistry parameters., Module 1 - Cohort A: -Investigator assessment, as defined by RECIST version 1.1: - DoR - Percentage change in tumour size - PFS, Module 1 - Cohort B: -ORR by RECIST 1.1 for soft tissue and visceral lesions and by PCWG3 criteria for bone lesions. -Proportion of participants with confirmed CTC count conversion from unfavourable to favourable. -Proportion of participants with confirmed PSA decline > 50%. -Best percentage change in tumour size. -Duration of radiological responses -Radiological PFS using RECIST 1.1 for soft tissues and visceral lesions and PCWG3 for bone lesions.

Source: https://euclinicaltrials.eu/ctis-public/view/2024-515102-12-00